EU clinical trial 2024-513282-39-00: A randomized, double-blind, double-dummy, placebo-controlled, multicenter, Phase 3 study assessing the efficacy, safety, and tolerability of 2 doses of remibrutinib over a 68-week treatment period in adult and adolescent patients with moderate to severe hidradenitis suppurativa (RECHARGE-1)
Protocol code: CLOU064J12301
Sponsor: Novartis Pharma AG (Pharmaceutical company). Phase: Therapeutic confirmatory (Phase III). Countries: Bulgaria (ongoing, recruitment ended), Poland (ongoing, recruitment ended), Germany (ongoing, recruitment ended), Spain (ongoing, recruitment ended), Italy (ongoing, recruitment ended), Portugal (ongoing, recruitment ended), Greece (ongoing, recruitment ended), Denmark (ongoing, recruitment ended), Slovakia (ongoing, recruitment ended).
Therapeutic area(s): Diseases [C] - Immune System Diseases [C20]
Gender: Female, Male. Age: 0-17 years, 18-64 years, 65+ years. Enrolment: 205.
Status: Ongoing, recruitment ended. Start date (EU): 2025-05-28. Decision date: 2025-05-12. Results received: No. Last updated: 2026-06-10.
Decision dates by country: GR: 2025-05-13, PT: 2025-05-13, ES: 2025-05-12, PL: 2025-05-19, IT: 2025-05-13, SK: 2025-05-12, DK: 2025-05-13, DE: 2025-05-12, BG: 2025-05-13

Condition(s): Hidradenitis Suppurativa (HS)
Product: LOU064, TRIAMCINOLONE, Placebo to Remibrutinib (LOU064) 0 mg matching 00 mg film-coated tablet, Placebo to Remibrutinib (LOU064) 0 mg matching 00 mg film-coated tablet, LOU064, CLINDAMYCIN

Primary endpoint: Achievement of HiSCR50 at Week 16. HiSCR50 is defined as at least a 50% decrease in Abscess and Inflammatory Nodule (AN) count with no increase in the number of abscesses and in the number of draining tunnels/fistulae compared to baseline.
Endpoint(s): Achievement of AN50 at Week 16. AN50 is defined as at least a 50% decrease in Abscess and Inflammatory Nodule (AN) count compared to baseline, Percentage change from baseline in IHS4 at Week 16, Achievement of HiSCR75 at Week 16. HiSCR75 is defined as at least a 75% decrease in Abscess and Inflammatory Nodule (AN) count with no increase in the number of abscesses and in the number of draining tunnels/fistulae compared to baseline., Flaring up to Week 16. Flare is defined as at least a 25% increase in AN count with a minimum increase of 2 AN relative to baseline., Achievement of HiSCR50 at Week 8., Achievement of HiSCR90 at Week 16. HiSCR90 is defined as at least a 90% decrease in Abscess and Inflammatory Nodule (AN) count with no increase in the number of abscesses and in the number of draining tunnels/fistulae compared to baseline., Achievement of NRS30 at Week 16, among participants with baseline NRS ≥ 3 (pooled data from studies CLOU064J12301 and CLOU064J12302). NRS30 is defined as at least a 30% reduction and at least 2-unit reduction from baseline in Patient's Global Assessment of Skin Pain - at worst over the past 7 days, Occurrence of treatment emergent adverse events and serious adverse events during the study

Source: https://euclinicaltrials.eu/ctis-public/view/2024-513282-39-00